EU clinical trial 2024-513397-21-00: Isatuximab and Autologous Hematopoietic Stem Cell Transplantation for Relapsed Multiple Myeloma Patients (Isabel study)
Protocol code: ISABEL
Sponsor: Emn Trial Office S.r.l. Impresa Sociale (Laboratory/Research/Testing facility). Phase: Therapeutic exploratory (Phase II). Countries: Italy (ongoing, recruitment ended).
Therapeutic area(s): Diseases [C] - Neoplasms [C04]
Gender: Female, Male. Age: 18-64 years, 65+ years. Enrolment: 25.
Status: Ongoing, recruitment ended. Start date (EU): 2021-09-16. Decision date: 2024-07-31. Results received: No. Last updated: 2026-05-08.

Condition(s): Relapsed Multiple Myeloma
Product: SOLDESAM 4 mg/1 ml soluzione iniettabile, SARCLISA 20mg/mL concentrate for solution for infusion., SOLDESAM 0,2% gocce orali, soluzione, SARCLISA 20mg/mL concentrate for solution for infusion., SOLDESAM 8 mg/2 ml soluzione iniettabile

Primary endpoint: The rate of MRD negativity is determined as the proportion of patients with NGF MRD negativity (10-5 sensitivity level) within 12 months after ASCT using the intention-to-treat principle. For patients who withdraw from the study or are lost to follow up before this timepoint, the best MRD assessment will be considered. Patients will be classified as MRD positive if they have only MRD positive test results or do not undergo MRD assessment.
Endpoint(s): Response rate (sCR, CR, VGPR, PR, ORR) will be evaluated according to IMWG Response criteria after induction, transplant and maintenance., TTP will be measured from the date of ICF to the date of first observation of PD, or deaths for PD. Subjects who have not progressed or who withdraw from the study or die from causes other than PD will be censored at the time of the last complete disease assessment. Subjects lost to follow-up will also be censored at the time of last complete disease assessment, PFS will be measured from the date of ICF to the date of first observation of PD, or death from any cause as an event. Subjects who have not progressed or who withdraw from the study or who were lost to follow-up will be censored at the time of the last complete disease assessment., TNT will be measured from the date of eligibility confirmation to the date of next anti-myeloma therapy. Death due to any cause before starting therapy will be considered an event. Subjects who have not progressed or who withdraw from the study will be censored at the time of the last complete disease assessment. Subjects lost to FU will also be censored at the time of last contact., PFS2 will be measured from the date of ICF to the date of observation of second disease progression or death to any cause as an event. In case of date of second progression is not available, date of start of third line treatment can be used. Subjects who have not progressed or who withdraw from the study will be censored at the time of the last complete disease assessment. All subjects who were lost to follow-up prior to the end of the study, h, OS is defined as the time between ICF date and death, regardless cause of death. Subjects who withdraw consent will be censored at the time of withdrawal. Subjects who are still alive at the cut-off date of final analysis will be censored at the cut-off date. Subjects lost to FU will also be censored at the time of last contact, DOR is defined as time between first documentation of response (achievement of at least a PR) and PD with deaths owning to causes other than progression not counted, but censored. Responders without disease progression at the cut-off date of final analysis will be censored either at the time of lost to follow-up, at the time of death due to other cause than PD, or at the time of last contact., Time to PR will be measured from the date of ICF to the date of first observation of PR Subjects who achieved response better than PR will be consider that PR is achieved. Subjects who withdraw from the study will be censored at the time of the last complete disease assessment. Subjects have not achieved a PR, and are still alive at the cut-off date of final analysis will be censored at the cut-off date. All subjects who were lost to FU will also be censored at the time of last contact., Time to VGPR will be measured from the date of ICF to the date of first observation of VGPR (Very Good Partial Response). Subjects who achieved response better than VGPR will be consider that VGPR is achieved. Subjects who withdraw from the study will be censored at the time of the last complete disease assessment. Subjects have not achieved a VGPR, and are still alive at the cut-off date of final analysis will be censored at the cut-off date. All subjects who were lost to FU will also be censor, Time to CR will be measured from the date of ICF to the date of first observation of CR.Subjects who achieved response better than CR will be consider that CR is achieved. Subjects who withdraw from the study will be censored at the time of the last complete disease assessment. Subjects have not achieved a CR, and are still alive at the cut-off date of final analysis will be censored at the cut-off date. All subjects who were lost to FU will also be censored at the t, Time to sCR will be measured from the date of ICF to the date of first observation of sCR (stringent Complete Partial Response). Subjects who withdraw from the study will be censored at the time of the last complete disease assessment. Subjects have not achieved a sCR, and are still alive at the cut-off date of final analysis will be censored at the cut-off date. All subjects who were lost to FU will also be censored at the time of last contact. Difference will be calculated in 30-day months., Rate of 1 year sustained MRD negativity by NGF will be also evaluated, and correlated with PFS and OS., The rate of MRD negativity is determined as the proportion of patients with NGF MRD negativity (10-5 sensitivity level) within 12 months after ASCT using the intention-to-treat principle. For patients who withdraw from the study or are lost to follow up before this timepoint, the best MRD assessment will be considered. Patients will be classified as MRD positive if they have only MRD positive test results or do not undergo MRD assessment., The 24 months MRD negativity rate is determined as the proportion of patients with MRD negativity (≥10-5 sensitivity level, NGF) after 12 months using ITT principle. Patients will be classified as MRD positive if they have only MRD positive test results or do not undergo MRD assessment/sample not adequate., The analysis of safety as defined by type, frequency and severity will be done primarily by tabulation of the incidence of Adverse Events as defined by the National Cancer Institute (NCI) Common Terminology Criteria for Adverse Events (CTCAE), version 5.0. In the by-subject analysis, a subject having the same event more than once will be counted only once. Adverse Events will be summarized by worst CTCAE grade., Dose reduction will be done primarily by tabulation of the incidence of dose reduction and causes., Time to discontinuation will be measured from the date of first dose of study drugs to the date of discontinuation due to AE or Death for AE/SPM. Subjects who discontinued drugs due to PD, or death for cause other than AE/SPM will be considered a competitive event. Subjects has not discontinued, and are still alive and on treatment at the cut-off date of final analysis will be censored at the cut-off date. All subjects who were lost to FU will also be censored at the time of last contact., Relative dose will be evaluated consider the ration between the administered and the planned dose. Relative dose will be estimated for each study drugs.

Source: https://euclinicaltrials.eu/ctis-public/view/2024-513397-21-00